EU clinical trial 2022-503050-39-00: A Multicenter, Randomized, Double-blind, Chronic-dosing, Parallel-group, Placebo-controlled Phase 3 Study to Evaluate the Efficacy and Safety of Benralizumab 100 mg in Patients with Moderate to Very Severe Chronic Obstructive Pulmonary Disease (COPD) with a History of Frequent COPD Exacerbations and Elevated Peripheral Blood Eosinophils (RESOLUTE)
Protocol code: D3251C00014
Sponsor: AstraZeneca AB (Pharmaceutical company). Phase: Therapeutic confirmatory (Phase III). Countries: Netherlands (ended), Spain (ended), Sweden (ended), Denmark (ended), Italy (ended), Hungary (ended), Belgium (ended), Austria (ended), Poland (ended), Germany (ended), Czechia (ended), Greece (ended), Bulgaria (ended).
Therapeutic area(s): Diseases [C] - Respiratory Tract Diseases [C08]
Gender: Female, Male. Age: 18-64 years, 65+ years. Enrolment: 236.
Status: Ended. Start date (EU): 2019-11-12. End date (EU): 2025-07-10. End date: 2025-07-28. Decision date: 2023-05-04. Results received: Yes. Last updated: 2025-09-15.
Decision dates by country: BG: 2023-10-20, AT: 2023-07-18, DK: 2023-05-09, NL: 2023-05-04, BE: 2023-06-08, HU: 2023-05-05, CZ: 2023-06-15, DE: 2023-06-13, PL: 2023-07-19, IT: 2023-05-11, ES: 2023-05-05, SE: 2023-05-05, GR: 2023-06-12

Condition(s): Moderate to Very Severe Chronic Obstructive Pulmonary Disease (COPD) with a History of Frequent COPD Exacerbations and Elevated Peripheral Blood Eosinophils
Product: Placebo for benralizumab for clinical trials is a sterile liquid solution presented in an accessorized prefilled syringe (apfs) for subcutaneous injection., Benralizumab

Primary endpoint: Annualized rate of moderate or severe COPD exacerbations, where a COPD exacerbation is defined by symptomatic worsening of COPD requiring: • Use of systemic corticosteroids for at least 3 days; a single depot injectable dose of corticosteroids will be considered equivalent to a 3-day course of systemic corticosteroids; and/or • Use of antibiotics; and/or • An inpatient hospitalization or death due to COPD
Endpoint(s): Annualized rate of severe COPD exacerbations, where a severe COPD exacerbation is defined by symptomatic worsening of COPD requiring an inpatient hospitalization or results in death due to COPD, Annualized rate of COPD exacerbations that are associated with an emergency room/emergency department visit or a hospitalization due to COPD, Time to first COPD exacerbation, - SGRQ total and domain scores - CAT total score, E-RS:COPD total and domain scores, Change from baseline in pre-dose/pre-bronchodilator FEV1 at the study site, Mortality rate, Annual rate of hospitalizations due to COPD; Length of hospital stay; ICU days; annual rate of hospitalizations and emergency department visits combined due to COPD; annual rate of unscheduled outpatient visits including unscheduled visits to study sites due to COPD; and annual rate of unscheduled healthcare encounters due to COPD, - Serum benralizumab concentration - Anti-benralizumab antibodies

Source: https://euclinicaltrials.eu/ctis-public/view/2022-503050-39-00